EU clinical trial 2023-505030-99-00: First administration in healthy volunteers of a single and increasing dose of a new molecule for the treatment of brain diseases
Protocol code: RT-IS-G-H-2301
Sponsor: Rest Therapeutics (Pharmaceutical company). Phase: Human Pharmacology (Phase I)- First administration to humans. Countries: Belgium (not authorised).
Therapeutic area(s): Psychiatry and Psychology [F] - Mental Disorders [F03]; Diseases [C] - Nervous System Diseases [C10]
Gender: Male. Age: 18-64 years. Enrolment: 36.
Status: Not authorised. Decision date: 2023-07-11. Results received: No. Last updated: 2023-07-11.

Condition(s): Post-Traumatic Stress Disorder (PTSD)

Source: https://euclinicaltrials.eu/ctis-public/view/2023-505030-99-00